EU clinical trial 2024-517808-11-00: A randomized, triple-blind, placebo-controlled study on the effect of rifaximin on psychobiological functions in healthy men.
Protocol code: S66407
Sponsor: UZ Leuven (Hospital/Clinic/Other health care facility). Phase: Therapeutic exploratory (Phase II). Countries: Belgium (ended).
Therapeutic area(s): Phenomena and Processes [G] - Physiological processes [G07]; Psychiatry and Psychology [F] - Psychological Phenomena [F02]; Phenomena and Processes [G] - Microbiological Phenomena [G06]
Gender: Male. Age: 18-64 years. Enrolment: 60.
Status: Ended. Start date (EU): 2022-10-01. End date (EU): 2025-10-15. Decision date: 2024-11-04. Results received: No. Last updated: 2024-11-04.

Condition(s): Healthy volunteers
Product: TARGAXAN 550 mg Filmtabletten, The placebo tablets are white to off-white tablets with a mean weight of 488 mg, minimum hardness of 50 N and a mean thickness of about 5.7 mm. The following formula will be used in the manufacturing of the placebo tablets: Ingredient Amount/tablet Lactose monohydrate 320 mg; Carmellose Sodium 10 mg; Corn starch 70 mg; Cellulose microcrystalline 55 mg; Sillicium dioxide anhydrous 20 mg; Magnesium stearate 13 mg; Total tablet weight 488 mg

Primary endpoint: Psychobiological readouts related to stress and fear tasks, including salivary cortisol levels, subjective visual analogue scale (VAS) stress reports, skin conductance levels, and expectancy of dangerous stimulus (expectancy ratings)
Endpoint(s): Gut microbiota profile, heart rate variability, SCFA levels, inflammatory marker profile (cytokine panel and C-reactive protein levels), fMRI BOLD responses to stress, and brain metabolite concentration

Source: https://euclinicaltrials.eu/ctis-public/view/2024-517808-11-00